EU clinical trial 2025-523990-40-00: Accelerate Improvement in Multiple Myeloma for Newly Diagnosed Transplant-Eligible Patients (AugMMent)
Protocol code: GMMG-HD11/DSMM XXI
Sponsor: Universitaetsklinikum Heidelberg AöR (Hospital/Clinic/Other health care facility). Phase: Therapeutic confirmatory (Phase III). Countries: Germany (ongoing, recruiting).
Therapeutic area(s): Diseases [C] - Hemic and Lymphatic Diseases [C15]
Gender: Female, Male. Age: 18-64 years, 65+ years. Enrolment: 399.
Status: Ongoing, recruiting. Start date (EU): 2026-07-07. Decision date: 2026-06-09. Results received: No. Last updated: 2026-06-09.

Condition(s): Newly diagnosed Multiple Myeloma in patients eligible for stem cell transplantation
Product: Lenalidomid AL 25 mg Hartkapseln, teclistamab, Lenalidomid AL 15 mg Hartkapseln, VELCADE 3.5 mg powder for solution for injection, teclistamab, DARZALEX 1800 mg solution for injection, Lenalidomid AL 5 mg Hartkapseln, Lenalidomid AL 10 mg Hartkapseln, DEXAMETHASONE

Primary endpoint: Cumulative MRD negativity by NGS at a sensitivity level of 10^-6 before start of maintenance therapy.
Endpoint(s): Sustained (≥12 months) cumulative MRD-negative CR rate (10^-6) by NGS up to 24 months of maintenance therapy., The cumulative rate of the composite endpoint of events (within 24 months of maintenance therapy) per patient and month of therapy. Events of relevance include: Grade 3 or Grade 4 infection; Pause of more than 62 days of all study treatments considering death, progression, and discontinuation of all treatments.

Source: https://euclinicaltrials.eu/ctis-public/view/2025-523990-40-00